EU clinical trial 2024-517444-64-00: A Phase I/II Open-Label Study to Assess the Safety, Tolerability and Preliminary Efficacy of the Clever-1 Antibody Bexmarilimab in Combination with Standard of Care Therapy in Patients with Myelodysplastic Syndrome or Chronic Myelomonocytic Leukemia or Acute Myeloid Leukemia (BEXMAB Study)
Protocol code: FP2CLI004
Sponsor: Faron Pharmaceuticals Oy (Pharmaceutical company). Phase: Phase I and Phase II (Integrated)- Other. Countries: Finland (ended).
Therapeutic area(s): Diseases [C] - Hemic and Lymphatic Diseases [C15]
Gender: Female, Male. Age: 18-64 years, 65+ years. Enrolment: 137.
Status: Ended. Start date (EU): 2022-05-30. End date (EU): 2026-02-03. Decision date: 2024-10-11. Results received: No. Last updated: 2026-02-06.

Condition(s): Chronic Myelomonocytic Leukemia, Myelodysplastic Syndrome, Acute Myeloid Leukemia
Product: Bexmarilimab

Primary endpoint: Phase I - 1. Reporting of incidence and frequency of dose limiting toxicities (DLTs), and frequency and severity of adverse events (AE), SAEs and laboratory abnormalities., Phase II - 1. Preliminary efficacy will be investigated per indication as follows: - Complete response (CR) rate for MDS and CMML-2. - Overall response rate (ORR) for MDS and CMML failure to prior HMA. - CR for r/r AML. - CR rate for newly diagnosed AML.
Endpoint(s): Phase I - 1. Clinical efficacy measures include disease-specific response criteria and progression and survival analyses., Phase I - 2. PK samples at defined timepoints of single and repeat bexmarilimab administration and derived PK parameters., Phase I - 3. Anti-bexmarilimab antibody detection., Phase II - 1. Frequency and severity based on NCI-CTCAE v 5.0 grading of adverse events (AE), SAE and laboratory abnormalities., Phase II - 2. Extended preliminary efficacy to include disease-specific response criteria and progression and survival analyses., Phase II - 3. Anti-bexmarilimab antibody (immunogenicity) detection.

Source: https://euclinicaltrials.eu/ctis-public/view/2024-517444-64-00